EU clinical trial 2025-521034-28-00: A Phase II, Multicenter, Double-Blind, Placebo-Controlled Study to Assess the Efficacy and Safety of RO7790121 in Patients with Moderate to Severe Rheumatoid Arthritis who have an Inadequate Response or Intolerance to TNF and/or JAK Inhibitors
Protocol code: WA45846
Sponsor: F. Hoffmann-La Roche AG (Pharmaceutical company). Phase: Therapeutic exploratory (Phase II). Countries: Italy (authorised, recruiting), Denmark (ongoing, recruiting), France (authorised, recruiting), Poland (ongoing, recruiting), Germany (ongoing, recruiting), Spain (ongoing, recruiting), Belgium (authorised, recruiting).
Therapeutic area(s): Phenomena and Processes [G] - Immune System Phenomena [G13]; Diseases [C] - Immune System Diseases [C20]
Gender: Female, Male. Age: 18-64 years, 65+ years. Enrolment: 63.
Start date (EU): 2025-12-05. Decision date: 2025-11-23. Results received: No. Last updated: 2026-07-16.
Decision dates by country: BE: 2025-11-25, FR: 2025-11-25, DE: 2025-11-25, IT: 2025-11-24, PL: 2025-11-25, DK: 2025-11-23, ES: 2025-11-26

Condition(s): Moderate to Severe Rheumatoid Arthritis (RA)
Product: RO7790121, RO7790121 placebo

Primary endpoint: Change from baseline in DAS28-CRP at Week 14
Endpoint(s): ACR20 response rate at Week 14, ACR50 response rate at Week 14, ACR70 response rate at Week 14, Change from baseline in DAS28-ESR at Week 14, Change from baseline in SDAI score at Week 14, Change from baseline in CDAI score at Week 14, Change from baseline in SF-36 score at Week 14, Incidence and severity of the following: - Adverse events - Serious adverse events - Adverse events leading to study treatment discontinuation - Adverse events of special interest - Change from baseline in selected vital signs - Change from baseline in selected clinical laboratory test results, Serum concentration of RO7790121 at specified timepoints

Source: https://euclinicaltrials.eu/ctis-public/view/2025-521034-28-00